EU clinical trial 2023-507207-66-00: A Phase 3 Double-masked, Randomized, Multicenter Study of the Efficacy and Safety of OCS-01 Eye Drops in Subjects With Diabetic Macular Edema
Protocol code: DX221
Sponsor: Oculis Operations S.a.r.l. (Pharmaceutical company). Phase: Therapeutic confirmatory (Phase III). Countries: Italy (ended), France (ended), Germany (ended), Spain (ended), Czechia (ended), Bulgaria (ended).
Therapeutic area(s): Phenomena and Processes [G] - Ocular Physiological Phenomena [G14]
Gender: Female, Male. Age: 18-64 years, 65+ years. Enrolment: 133.
Status: Ended. End date (EU): 2024-07-29. Decision date: 2024-05-20. Results received: No. Last updated: 2024-05-24.
Decision dates by country: BG: 2024-05-23, CZ: 2024-05-21, FR: 2024-05-22, DE: 2024-05-24, IT: 2024-05-23, ES: 2024-05-20

Condition(s): Diabetic Macular Edema (DME)
Product: Eye drops, suspension, ocular use

Primary endpoint: The primary endpoint is mean change in Best Corrected Visual Acuity (BCVA) Early Treatment Diabetic Retinopathy Study (ETDRS) letters score at Visit 12 (Week 52) compared with baseline.
Endpoint(s): The proportion of subjects with a 3-line or greater gain in BCVA assessed with the ETDRS scale at Visit 12 (Week 52) compared with baseline., Other Secondary Efficacy: • Area under the curve (AUC) of BCVA ETDRS letter changes across postbaseline visits up to Visit 12 (Week 52). • Mean change in central subfield thickness (CST) as measured by SD-OCT at Visit 12 (Week 52) compared with baseline., Other Secondary Efficacy:• Mean change in CST as measured by SD-OCT at each postbaseline visit compared with baseline.• Mean change in BCVA ETDRS letters score at each postbaseline visit compared with baseline. • The proportion of subjects with a 3-line or greater gain in BCVA assessed with the ETDRS scale at each postbaseline visit., Safety Endpoints: • Adverse events (AEs) • Intraocular pressure (IOP) • Hemoglobin A1c (HbA1c) • Lens clarity grading • Endothelial cell counts • Hematology • Serum chemistry • Blood pressure

Source: https://euclinicaltrials.eu/ctis-public/view/2023-507207-66-00